EU clinical trial 2024-519015-34-00: A Study to Investigate Safety, Tolerability, Pharmacokinetics, and Pharmacodynamics of AZD5492 in Adult Participants with Systemic Lupus Erythematosus or Idiopathic Inflammatory Myopathies or Rheumatoid Arthritis.
Protocol code: D9961C00001
Sponsor: AstraZeneca AB (Pharmaceutical company). Phase: Human Pharmacology (Phase I)- First administration to humans. Countries: France (ongoing, recruiting), Netherlands (authorised, recruiting), Spain (ongoing, recruiting), Germany (authorised, recruiting).
Therapeutic area(s): Diseases [C] - Immune System Diseases [C20]
Gender: Female, Male. Age: 18-64 years, 65+ years. Enrolment: 32.
Start date (EU): 2025-06-30. Decision date: 2025-06-18. Results received: No. Last updated: 2026-07-13.
Decision dates by country: ES: 2025-06-18, DE: 2025-06-23, FR: 2025-06-19, NL: 2025-06-20

Condition(s): Idiopathic Inflammatory Myopathies, Rheumatoid Arthritis, Systemic Lupus Erythematosus

Source: https://euclinicaltrials.eu/ctis-public/view/2024-519015-34-00